EU clinical trial 2024-518038-10-00: A randomised, assessor-blinded, controlled, healthy volunteer, Phase I study to assess skin irritation and sensitization potential of a novel 5% lidocaine medicated plaster
Protocol code: 24EU-Lip03
Sponsor: IBSA Institut Biochimique SA (Pharmaceutical company). Phase: Human Pharmacology (Phase I)- Other. Countries: France (ended).
Therapeutic area(s): Diseases [C] - Nervous System Diseases [C10]
Gender: Female, Male. Age: 18-64 years, 65+ years. Enrolment: 260.
Status: Ended. Start date (EU): 2025-05-12. End date (EU): 2026-01-09. Decision date: 2025-04-04. Results received: No. Last updated: 2025-12-04.

Condition(s): None. Healthy subjects

Source: https://euclinicaltrials.eu/ctis-public/view/2024-518038-10-00